EU clinical trial 2024-515484-54-00: Safety and efficacy of a human albumin solution with restored structural profile in patients with decompensated cirrhosis
Protocol code: RESTORE
Sponsor: Azienda Ospedaliero-Universitaria Di Bologna IRCCS Istituto Di Ricerca E Di Cura A Carattere Scientifico (Hospital/Clinic/Other health care facility). Phase: Therapeutic exploratory (Phase II). Countries: Italy (ongoing, recruiting).
Therapeutic area(s): Diseases [C] - Pathological Conditions, Signs and Symptoms [C23]; Diseases [C] - Digestive System Diseases [C06]
Gender: Female, Male. Age: 18-64 years, 65+ years. Enrolment: 88.
Status: Ongoing, recruiting. Start date (EU): 2025-09-01. Decision date: 2024-10-30. Results received: No. Last updated: 2026-05-06.

Condition(s): decompensated cirrhosis
Product: RITION Glutatione, Albunorm 20% "200 g/l, soluzione per infusione"

Primary endpoint: Primary endpoints of the study will be: - Effective albumin concentration at 1, 3 and 6 months from randomization - Safety of the reHA solution during the 6-month treatment assessed by collecting vital signs, lab parameters and any adverse event, namely: • Percentage of subjects with at least 1 adverse event (AE) or serious adverse event (SAE); • Percentage of subjects with at least 1 Adverse Drug Reaction (ADR); •Total number of AE, SAE and ADR; [truncated text, see protocol for details]
Endpoint(s): Signals of efficacy will be searched by comparing the following parameters at 1, 3 and 6 months from randomization: Organ function: Liver function: grade of ascites (International Club of Ascites criteria), grade of HE (West Haven classification and Animal Naming Test), bilirubin and albumin serum levels; Renal function: BUN, serum creatinine, electrolytes, eGFR estimated by the CKD-EPI equation;[truncated text, see protocol for details]

Source: https://euclinicaltrials.eu/ctis-public/view/2024-515484-54-00